EU clinical trial 2023-503301-10-00: Daridorexant to treat insomnia in patients with mild cognitive impairment and mild to moderate Alzheimer disease.
Protocol code: RECHMPL22_0529
Sponsor: Centre Hospitalier Universitaire De Montpellier (Hospital/Clinic/Other health care facility). Phase: Therapeutic use (Phase IV). Countries: France (ongoing, recruiting).
Therapeutic area(s): Diseases [C] - Nervous System Diseases [C10]
Gender: Female, Male. Age: 18-64 years, 65+ years. Enrolment: 62.
Status: Ongoing, recruiting. Start date (EU): 2023-12-14. Decision date: 2023-06-26. Results received: No. Last updated: 2026-06-19.

Condition(s): Insomnia Disorder; SLEEP; Alzheimer Disease
Product: Placebo matching daridorexant is provided as identitical-looking oral tablets, formulated with the same inactive ingredients (excipients) as the active tablets., QUVIVIQ 50 mg film-coated tablets

Primary endpoint: The change in Total Sleep Time (TST) from baseline to the end of each period (Month 1/Month 2) as assessed by polysomnography comparing daridorexant 50 mg with placebo.
Endpoint(s): Change in the wake time after sleep onset (WASO) from baseline to the end of each period (Month 1/Month 2) as assessed by polysomnography comparing daridorexant 50 mg with placebo., Changes in objective sleep parameters as assessed by polysomnography (LPS, percentage of sleep stages, wake bouts on the whole night and per quarter of the night) from baseline to the end of each period (Month 1/Month 2) comparing daridorexant 50 mg with placebo., Changes in sleep/wake parameters (sleep and wake duration, sleep efficiency) as assessed by actigraphy from baseline to the end of each period (Month 1/Month 2) comparing daridorexant 50 mg with placebo., Changes in self-reported sleep parameters (sleep questionnaires such as TST, insomnia on ISI, and excessive daytime sleepiness on ESS, IDSIQ total score, sleepiness, mood, and alert/cognition domain scores) from baseline to the end of each period (Month 1/Month 2) comparing daridorexant 50 mg with placebo., Change in depression (using the Beck Depression Inventory – BDI) and quality of life (using the EuroQol 5-Dimensional Descriptive System – EQ-5D) from baseline to the end of each period (Month 1/Month 2) with daridorexant 50 mg compared to placebo., Changes in cognition (episodic memory, executive function, verbal fluency…) and nocturnal agitation using the Neuropsychiatric Inventory (NPI) agitation/aggression domain from baseline to the end of each period (Month 1/Month 2) comparing daridorexant 50 mg with placebo., Decrease in blood pressure variability during polysomnography and increase in 24-hour blood pressure monitoring dipping pattern from baseline to the end of each period (Month 1/Month 2) comparing daridorexant 50 mg with placebo., Changes in blood AD biomarkers (Aβ42, Aβ40, Tau, P-Tau, neurofilament) and proinflammatory cytokines (TNFa, IL6) levels from baseline to the end of each period (Month 1/Month 2) comparing daridorexant 50 mg with placebo., Changes in objective sleep parameters as assessed by polysomnography according to baseline CSF AD biomarkers (Aβ42, Aβ40, Tau, P-Tau, neurofilament) and Orexin levels from baseline to the end of each period (Month 1/Month 2) comparing daridorexant 50 mg with placebo., CSF AD biomarkers (Aβ42, Aβ40, Tau, P-Tau, neurofilament) and CSF proinflammatory cytokines (TNFa, IL6) levels according to serum AD biomarkers (Aβ42, Aβ40, Tau, P-Tau, neurofilament) and serum proinflammatory cytokines (TNFa, IL6) levels at baseline., Rates of serious adverse events with treatment intake from baseline to the end of trial.

Source: https://euclinicaltrials.eu/ctis-public/view/2023-503301-10-00